EU clinical trial 2024-514352-32-00: GREEN A randomized, double-blind, multi-center, placebo-controlled, efficacity and safety study of glenzocimab used as an add-on therapy on top of mechanical thrombectomy for acute ischemic stroke
Protocol code: APHP201028
Sponsor: Assistance Publique Hopitaux De Paris (Hospital/Clinic/Other health care facility). Phase: Phase II and Phase III (Integrated). Countries: France (ended).
Therapeutic area(s): Diseases [C] - Nervous System Diseases [C10]
Gender: Female, Male. Age: 18-64 years, 65+ years. Enrolment: 260.
Status: Ended. Start date (EU): 2023-01-03. End date (EU): 2025-07-30. Decision date: 2024-10-07. Results received: No. Last updated: 2024-10-07.

Condition(s): Acute ischemic stroke
Product: 0.9% Sodium Chloride Solution, Glenzocimab

Primary endpoint: The primary efficacy endpoint is the functional outcome at day 90 assessed by the modified mRS at day 90 +/- 15 days.
Endpoint(s): Efficacy : • Favourable functional outcome defined by a mRS score ≤ 2 at day 90 • Proportion of patient with severe handicap (mRS 4-6) at Day 90 • Overall Survival at day-90 and 1 year • Early reperfusion outcomes: o Stroke volume by brain imaging at 24 hrs o Reperfusion at the end of MT procedure assessed by eTICI score o Early neurological improvement by NIHSS at 24 hrs • EQ-5D-5L at day 90 and 1 year, Safety: • Incidence of symptomatic or non-symptomatic ICH at 24 hrs • Incidence of symptomatic IntraCranial Hemorrhages (ICH) at 24 hrs • Incidence of non-symptomatic IntraCranial Hemorrhages (ICH) at 24 hrs • Incidence, nature and severity of Adverse Events, SAEs, SUSARs, Bleeding-Related Events (BREs) and Treatment-Emergent Adverse Events (TEAEs), at 24 hrs, at D7/discharge, 30 days and 90 days • Incidence of bleeding-related events at 90 days • Anti-glenzocimab, Cost -effectiveness • Cost per QALY (Quality adjusted Life Year) gained with the use of glenzocimab in addition to EVT • Cost per patient with a mRS score ≤ 2 gained with the use of glenzocimab in addition to EVT

Source: https://euclinicaltrials.eu/ctis-public/view/2024-514352-32-00